EU clinical trial 2024-513904-33-00: Longterm Follow-up of Subjects with Cerebral Adrenoleukodystrophy Who Were Treated with Lenti-D Drug Product
Protocol code: LTF-304
Sponsor: Genetix Biotherapeutics Inc. (Pharmaceutical company). Phase: Therapeutic confirmatory (Phase III). Countries: France (ongoing, recruitment ended), Germany (ongoing, recruitment ended), Italy (ongoing, recruitment ended), Netherlands (ongoing, recruitment ended).
Therapeutic area(s): Diseases [C] - Hemic and Lymphatic Diseases [C15]
Gender: Male. Age: 0-17 years. Enrolment: 11.
Status: Ongoing, recruitment ended. Start date (EU): 2020-03-11. Decision date: 2024-07-22. Results received: No. Last updated: 2026-07-03.
Decision dates by country: FR: 2024-07-29, DE: 2024-07-25, IT: 2024-08-07, NL: 2024-07-22

Condition(s): Cerebral Adrenoleukodystrophy (CALD)
Product: Elivaldogene autotemcel

Primary endpoint: Major functional disability (MFD)-free survival over time through Year 15 post-drug product infusion. Note: interim analyses (including evaluation of MFD-free survival [i.e., subjects who were alive without an MFD or need for hematopoietic stem cell transplant [HSCT]; also referred to as event-free survival by FDA) will occur once all subjects have completed 5 years and 10 years of post infusion follow-up (see Section 7.6.1)., The number of subjects with malignancies through 15 years post-drug product infusion, The number of subjects who experience graft versus host disease (GVHD) through 15 years post-drug product infusion, The number of subjects with immune-related AEs (e.g., autoimmune disorders, GVHD, opportunistic infections, HIV) through 15 years post drug product infusion, The number of subjects with new or worsening hematologic disorders through 15 years post-drug product infusion, The number of subjects with new or worsening neurologic disorders through 15 years post-drug product infusion
Endpoint(s): The number of subjects who undergo subsequent stem cell transplantation (i.e. second HSC infusion) through 15 years post-drug product infusion, Change from Baseline (defined in parent study) through Year 15 post drug product infusion in neurologic function score (NFS), The number of subjects without gadolinium enhancement (GdE) on MRI over time through Year 15 post-drug product infusion

Source: https://euclinicaltrials.eu/ctis-public/view/2024-513904-33-00